EU clinical trial 2024-514327-42-00: Phase II Study Of Tarlatamab Alone Or In Combination With Chemotherapy In Advanced Neuroendocrine Carcinomas Of The Digestive System Or Unknown Primary Origin
Sponsor: Grupo Espanol De Tumores Neuroendocrinos (Patient organisation/association). Phase: Therapeutic exploratory (Phase II). Countries: Spain (ongoing, recruitment ended), France (ended).
Therapeutic area(s): Diseases [C] - Neoplasms [C04]
Gender: Female, Male. Age: 18-64 years, 65+ years. Enrolment: 87.
Start date (EU): 2025-12-18. Decision date: 2025-09-10. Results received: No. Last updated: 2026-04-16.
Decision dates by country: FR: 2025-09-12, ES: 2025-09-10

Condition(s): Advanced neuroendocrine carcinomas (NECs) of the digestive system or unknown primary origin.
Product: Folinato cálcico Altan 50 mg polvo para solución inyectable EFG, Tarlatamab, Tarlatamab, Irinotecán Hospira 20 mg/mL concentrado para solución para perfusión EFG., Fluorouracilo Accord 50 mg/ml solución inyectable o para perfusión EFG

Primary endpoint: The primary endpoint for the first part of this study will be the Progression-free Survival (PFS) rate, defined as the percentage of patients without progression as defined by RECIST V1.1 criteria or death. PFS rate will be calculated for each treatment arm separately once 38 PFS events are reported in the first 54 patients included (27 per treatment arm)., The primary endpoint will be the 12-months Overall Survival (OS) rate, defined as the percentage of patients alive after 12 months from the first dose of study treatment. OS will consider death from any cause as an event. Patients alive and free of events at the date of the analysis will be censored at their last known contact. OS will be calculated for each treatment arm separately.
Endpoint(s): Objective response rate (ORR) according to RECIST V1.1 criteria, Disease control rate (DCR)., Duration of the response (DoR)., Progression-free survival (PFS)., Overall survival (OS)., Health-related quality of life (HRQoL), assessed through the European Organization for Research and Treatment of Cancer Quality of Life Questionnaire C30 (EORTC QLQ-C30) version 3, Efficacy variables will be reported for subgroups to find potential correlation between patient characteristics (i.e. age, gender, ECOG, AJCC stage, differentiation, or previous treatments) and the clinical outcomes to tarlatamab., Frequency and severity of adverse events and Treatment-related adverse events (TRAEs) assessed by NCI CTCAE v5.0., Blood biomarkers., Correlation between clinical and molecular determinants and efficacy of tarlatamab., Frequency of AEs leading to treatment discontinuation.

Source: https://euclinicaltrials.eu/ctis-public/view/2024-514327-42-00